EU clinical trial 2023-508528-36-00: A randomized, double-blind, placebo-controlled, 2-arm Phase III study to assess efficacy and safety of xevinapant and radiotherapy compared to placebo and radiotherapy for demonstrating improvement of disease-free survival in participants with resected squamous cell carcinoma of the head and neck, who are at high-risk for relapse and are ineligible for high-dose cisplatin
Protocol code: MS202359_0002
Sponsor: Merck Healthcare KGaA (Pharmaceutical company). Phase: Therapeutic confirmatory (Phase III). Countries: Greece (ended), Austria (ended), Belgium (ended), Spain (ended), Czechia (ended), Portugal (ended), Poland (ended), Romania (ended), Italy (ended), France (ended), Netherlands (ended), Germany (ended).
Therapeutic area(s): Diseases [C] - Neoplasms [C04]
Gender: Female, Male. Age: 18-64 years, 65+ years. Enrolment: 262.
Status: Ended. Start date (EU): 2022-12-16. End date (EU): 2024-08-27. End date: 2024-08-28. Decision date: 2024-02-21. Results received: Yes. Last updated: 2024-09-16.
Decision dates by country: BE: 2024-02-23, NL: 2024-02-22, AT: 2024-02-26, CZ: 2024-02-23, DE: 2024-02-22, GR: 2024-03-22, PT: 2024-02-22, PL: 2024-02-29, RO: 2024-02-26, IT: 2024-03-06, FR: 2024-03-13, ES: 2024-02-21

Condition(s): Resected squamous cell carcinoma of the head and neck
Product: xevinapant, Xevinapant Placebo

Primary endpoint: Disease-Free Survival (DFS)

Source: https://euclinicaltrials.eu/ctis-public/view/2023-508528-36-00